EU clinical trial 2024-513158-32-01: Exploratory, longitudinal study to define changes in muscle, tendon and neural properties after botuline neurotoxin type A (BoNT) treatment of spastic equinovarus in first-ever stroke patients: a pilot study
Sponsor: UZ Leuven (Hospital/Clinic/Other health care facility). Phase: Phase III and phase IV (Integrated). Countries: Belgium (ongoing, recruiting).
Therapeutic area(s): Diseases [C] - Musculoskeletal Diseases [C05]
Gender: Female, Male. Age: 18-64 years, 65+ years. Enrolment: 12.
Status: Ongoing, recruiting. Start date (EU): 2025-08-14. Decision date: 2024-12-02. Results received: No. Last updated: 2024-12-02.

Condition(s): spastic equinovarus in stroke patients
Product: Dysport 500 U, poudre pour solution injectable

Primary endpoint: 1) Primary outcome parameters measured by 3DfUS muscle volume., 2) Primary outcome parameters measured by ISA The primary outcome parameter to determine the neural contributions to hyperresistance will be derived from the fast stretch: muscle activity (root mean square (RMS) EMG [uV].

Source: https://euclinicaltrials.eu/ctis-public/view/2024-513158-32-01